EU clinical trial 2023-504602-11-00: Effects of Dopaminergic Therapy in Patients with Alzheimer's Disease: A 24 weeks prospective, randomized, double-blind, placebo-controlled, parallel group, international, multi-center phase III study evaluating efficacy and safety of rotigotine 4mg/24 hrs in combination with rivastigmine 9.5 mg/24 hrs in mild to moderate Alzheimer's disease patients.
Protocol code: DOPAD-3
Sponsor: Fondazione Santa Lucia IRCCS (Hospital/Clinic/Other health care facility). Phase: Therapeutic confirmatory (Phase III). Countries: Italy (ongoing, recruiting), Germany (ongoing, recruiting), Czechia (ended), Spain (authorised, recruitment pending).
Therapeutic area(s): Diseases [C] - Nervous System Diseases [C10]
Gender: Female, Male. Age: 18-64 years, 65+ years. Enrolment: 378.
Start date (EU): 2023-10-25. Decision date: 2023-09-18. Results received: No. Last updated: 2026-03-24.
Decision dates by country: DE: 2023-09-20, CZ: 2023-09-18, IT: 2023-09-19, ES: 2025-04-08

Condition(s): Mild to moderate Alzheimer's disease
Product: Neupro 4mg/24h transdermal patch, Identical with the MP patches but without the active substance, Neupro 2 mg/24 h transdermal patch

Primary endpoint: ● to evaluate efficacy of rotigotine in combination with rivastigmine on frontal lobe cognitive functions as compared to rivastigmine in combination with placebo (change from Baseline to Week 24 in the FAB);

Source: https://euclinicaltrials.eu/ctis-public/view/2023-504602-11-00